EU clinical trial 2024-516272-14-00: PRODIG : Prevention of new onset diabetes after transplantation by a short term treatment of Vildagliptin in the early post-transplant period
Protocol code: N/2015/70
Sponsor: Centre Hospitalier Regional Universitaire (Hospital/Clinic/Other health care facility). Phase: Therapeutic confirmatory (Phase III). Countries: France (ongoing, recruiting).
Therapeutic area(s): Phenomena and Processes [G] - Metabolism [G03]
Gender: Female, Male. Age: 18-64 years, 65+ years. Enrolment: 186.
Status: Ongoing, recruiting. Start date (EU): 2024-08-13. Decision date: 2024-08-13. Results received: No. Last updated: 2025-01-16.

Condition(s): renal transplant
Product: Galvus 50 mg tablets

Primary endpoint: the proportion of diabetic patients 1 year after transplantation, defined as one of the following proposals: - Patients receiving a diabetic treatment - Patients have a fasting glucose above 7 mmol/l - Patients with an abnormal oral glucose tolerance test (OGTT)
Endpoint(s): The glycated hemoglobin (HbA1c) 3 months, 6 months and 12 months after transplantation and Laboratory tests (creatinine, creatinine clearance, uric acid, CRP, lipid profile, blood sugar, liver and pancreas balance, blood count) 3 months, 6 months and 12 months after transplantation, The occurrence of acute rejection, infection, graft loss and patient death 3 months, 6 months and 12 months after transplantation,, The health related quality of life (ReTRANSQOL questionnaire) 8 days, 3 months, 6 months and 12 months after transplantation compared to the baseline,, The cost of the care and treatment up to one year after transplantation.

Source: https://euclinicaltrials.eu/ctis-public/view/2024-516272-14-00